EU clinical trial 2022-502546-26-00: A Phase IB, Randomized, Placebo-Controlled Study Evaluating the Safety, Pharmacokinetics, Pharmacodynamics, and Efficacy of Crovalimab for the Management of Acute Uncomplicated Vaso‑Occlusive Episodes (VOE) in Patients With Sickle Cell Disease (SCD)
Protocol code: BO42452
Sponsor: F. Hoffmann-La Roche AG (Pharmaceutical company). Phase: Human Pharmacology (Phase I)- Other. Countries: France (ended), Netherlands (ended), Spain (ended), Italy (ended).
Therapeutic area(s): Diseases [C] - Hemic and Lymphatic Diseases [C15]
Gender: Female, Male. Age: 0-17 years, 18-64 years. Enrolment: 16.
Status: Ended. Start date (EU): 2023-09-11. End date (EU): 2025-05-26. End date: 2025-08-15. Decision date: 2023-07-21. Results received: Yes. Last updated: 2025-08-18.
Decision dates by country: FR: 2023-07-25, IT: 2023-07-28, NL: 2023-07-21, ES: 2023-07-26

Condition(s): Sickle Cell Disease
Product: Crovalimab Placebo, Crovalimab

Primary endpoint: Incidence and severity of adverse events, with severity determined according to National Cancer Institute (NCI) Common Terminology Criteria for Adverse Events, Version 5.0 (CTCAE v5.0), Change from baseline in targeted vital signs and clinical laboratory test results, Incidence and severity of infusion-related reactions and hypersensitivity
Endpoint(s): Serum concentrations of crovalimab over time, Relationships between drug exposure and pharmacodynamics, efficacy, or safety endpoints of crovalimab (patients randomized to crovalimab), Change over time in PD biomarkers (CH50, free C5, sC5b-9), Time to improvement of the primary acute uncomplicated VOE from baseline, Prevalence of anti-drug antibodies (ADAs) at baseline and incidence of ADAs during the study

Source: https://euclinicaltrials.eu/ctis-public/view/2022-502546-26-00